EU clinical trial 2024-510777-18-00: An Open-label Study to Evaluate the Long-term Safety and Efficacy of CSL312 (Garadacimab) in the Prophylactic Treatment of Hereditary Angioedema
Protocol code: CSL312_3002
Sponsor: CSL Behring LLC (Pharmaceutical company). Phase: Therapeutic confirmatory (Phase III). Countries: Netherlands (ended), Germany (ended), Hungary (ended), Czechia (ended), Spain (ended).
Therapeutic area(s): Diseases [C] - Congenital, Hereditary, and Neonatal Diseases and Abnormalities [C16]
Gender: Female, Male. Age: 0-17 years, 18-64 years, 65+ years. Enrolment: 52.
Status: Ended. Start date (EU): 2021-06-15. End date (EU): 2025-11-20. End date: 2025-11-21. Decision date: 2024-05-01. Results received: Yes. Last updated: 2025-11-28.
Decision dates by country: CZ: 2024-05-02, HU: 2024-05-02, NL: 2024-05-01, ES: 2024-05-07, DE: 2024-05-01

Condition(s): Hereditary angioedema
Product: garadacimab

Primary endpoint: Number of subjects with treatment emergent adverse events (TEAEs), 2. Percentage of subjects with TEAEs, 3. TEAEs rates per injection, 4. TEAEs rates per subject year
Endpoint(s): 1. The time-normalized number (per month and year) of Hereditary Angioedema (HAE attacks) for the entire study., 2. The percentage reduction and the number of subjects experiencing at least ≥ 50% ≥ 70%, ≥ 90 or equal to 100% (attack free) reduction in the time-normalized number of HAE attacks on Treatment compared to Run-in Period., 3. The time-normalized number (per month and year) of HAE attacks requiring on-demand treatment in subjects on treatment., 4. The time-normalized number (per month and year) of moderate and/or severe HAE attacks in subjects on treatment, 5. Number and percentage of subjects rating their response to therapy as good or excellent., 6. The number and percentage of subjects experiencing TEAEs with CSL312., 7. The number and percentage of subjects experiencing adverse events of special interest (AESIs) with CSL312., 8. The number and percentage of subjects experiencing serious adverse events (SAEs), including deaths, with CSL312., 9. The number and percentage of subjects experiencing CSL312 induced anti-CSL312 antibodies with CSL312.

Source: https://euclinicaltrials.eu/ctis-public/view/2024-510777-18-00